EU clinical trial 2024-510751-34-00: Open label, two cohort (with and without imiglucerase), multicenter study to evaluate pharmacokinetics, safety, and efficacy of eliglustat in pediatric patients with Gaucher disease type 1 and type 3
Protocol code: EFC13738
Sponsor: Genzyme Corp. (Pharmaceutical company). Phase: Therapeutic confirmatory (Phase III). Countries: Spain (ended), France (ended), Italy (ended).
Therapeutic area(s): Diseases [C] - Congenital, Hereditary, and Neonatal Diseases and Abnormalities [C16]
Gender: Female, Male. Age: 0-17 years. Enrolment: 23.
Status: Ended. Start date (EU): 2019-03-26. End date (EU): 2025-12-23. End date: 2025-12-26. Decision date: 2024-04-26. Results received: Yes. Last updated: 2025-12-04.
Decision dates by country: FR: 2024-05-06, IT: 2024-06-12, ES: 2024-04-26

Condition(s): Gaucher's disease type I; Gaucher's disease type III
Product: Eliglustat, Cerezyme 400 Units Powder for concentrate for solution for infusion, Cerezyme 400 Units Powder for concentrate for solution for infusion, Eliglustat, Eliglustat, Cerezyme 400 Units Powder for concentrate for solution for infusion, Eliglustat

Primary endpoint: Assessment of pharmacokinetic (PK) parameter of eliglustat: Cmax ; Maximum concentration (Cmax) of eliglustat in plasma, Assessment of PK parameter of eliglustat: AUC ; Area under the plasma eliglustat concentration-time curve (AUC), Adverse Events; Number of adverse events in pediatric patients
Endpoint(s): Change in hemoglobin level; Absolute change from baseline for hemoglobin (g/dL) (Cohort 1 patients), Change in platelet count; Percent change from baseline for platelet count (Cohort 1 patients), Change in liver volume; Percent change from baseline for liver volume (Cohort 1 patients), Change in spleen volume; Percent change from baseline for spleen volume (Cohort 1 patients), Pulmonary disease improvement; Proportion of patients with improvement in pulmonary disease (Cohort 2 patients), Bone disease improvement; Proportion of patients with improvement in bone disease (Cohort 2 patients), Thrombocytopenia; Proportion of patients with improvement in thrombocytopenia (Cohort 2 patients), Quality of Life; Health-related quality of life will be measured by the Pediatric Quality of Life InventoryTM (PedsQLTM) questionnaires

Source: https://euclinicaltrials.eu/ctis-public/view/2024-510751-34-00